EU clinical trial 2022-500301-41-00: Theophylline Effects in the Fontan Circulation
Sponsor: Oslo University Hospital Hf (Hospital/Clinic/Other health care facility). Phase: Therapeutic exploratory (Phase II). Countries: Norway (ended).
Therapeutic area(s): Diseases [C] - Cardiovascular Diseases [C14]
Gender: Female, Male. Age: 0-17 years, 18-64 years. Enrolment: 10.
Status: Ended. Start date (EU): 2023-02-20. End date (EU): 2023-09-15. Decision date: 2022-09-21. Results received: Yes. Last updated: 2023-05-16.

Condition(s): Univentricular congenital heart disease with a Fontan-type surgical palliation
Product: Theo-Dur 200mg depottablett

Primary endpoint: Primary safety endpoints: a. Frequency of treatment emerged AE/SAE b. Freedom from participant dropout based on tolerability of the study intervention c. Number of participants requiring dose reduction after first serum concentration assessment. d. Freedom of arrhythmogenic side effects of the study treatment leading to patient dropout, Difference in oxygen uptake at aerobic threshold pre/post treatment.
Endpoint(s): Difference in total scores from SF-36 and EQ-5D questionnaires pre/post treatment, Difference in ventricular function as assessed by echocardiography at rest pre/post treatment, Difference in diffusion capacity pre/post treatment, Change in Apnea Hypopnea Index during home-based sleep study pre-/post-treatment

Source: https://euclinicaltrials.eu/ctis-public/view/2022-500301-41-00